EU clinical trial 2023-509605-77-00: A Study to Evaluate MEDI5752 in Subjects with Advanced Solid Tumors
Protocol code: D7980C00001
Sponsor: AstraZeneca AB (Pharmaceutical company). Phase: Human Pharmacology (Phase I)- First administration to humans. Countries: Portugal (ended), Netherlands (ended), Italy (ongoing, recruitment ended), Spain (ongoing, recruitment ended), France (ended).
Therapeutic area(s): Diseases [C] - Neoplasms [C04]
Gender: Female, Male. Age: 18-64 years, 65+ years. Enrolment: 205.
Start date (EU): 2019-06-27. Decision date: 2024-08-06. Results received: No. Last updated: 2026-06-19.
Decision dates by country: FR: 2024-08-14, NL: 2024-08-07, PT: 2024-08-08, IT: 2024-08-20, ES: 2024-08-06

Condition(s): Advanced solid tumours

Source: https://euclinicaltrials.eu/ctis-public/view/2023-509605-77-00